EU clinical trial 2024-518013-25-00: A Phase 2a Multicenter Platform Study of Investigational Products for the Treatment of Adult Subjects with Idiopathic Pulmonary Fibrosis
Protocol code: M25-268
Sponsor: AbbVie Deutschland GmbH & Co. KG (Pharmaceutical company). Phase: Therapeutic exploratory (Phase II). Countries: Greece (authorised, recruiting), Italy (authorised, recruitment pending), Sweden (authorised, recruitment pending), Germany (authorised, recruiting), Portugal (authorised, recruiting), Spain (authorised, recruitment pending), France (authorised, recruitment pending), Hungary (authorised, recruitment pending), Poland (authorised, recruiting), Bulgaria (authorised, recruiting), Romania (authorised, recruitment pending).
Therapeutic area(s): Diseases [C] - Respiratory Tract Diseases [C08]
Gender: Female, Male. Age: 18-64 years, 65+ years. Enrolment: 86.
Start date (EU): 2026-07-20. Decision date: 2026-03-10. Results received: No. Last updated: 2026-07-17.
Decision dates by country: GR: 2026-03-11, IT: 2026-03-10, BG: 2026-03-12, RO: 2026-03-16, FR: 2026-03-13, PT: 2026-03-12, HU: 2026-03-12, SE: 2026-03-11, ES: 2026-03-13, DE: 2026-03-12, PL: 2026-03-13

Condition(s): Idiopathic Pulmonary Fibrosis
Product: Placebo for ABBV-142

Primary endpoint: Absolute change from baseline in forced vital capacity (mL) at Week 24.
Endpoint(s): Absolute change from baseline in FVC (mL) at Week 52., Relative change from baseline in FVC (mL) at Week 24., Relative change from baseline in FVC (mL) at Week 52., Absolute and relative change from Baseline in FVC % predicted at Week 24., Absolute and relative change from Baseline in FVC % predicted at Week 52., Time to first ≥ 10% absolute decline in FVC% predicted., Time to first ≥ 5% absolute decline in FVC% predicted.

Source: https://euclinicaltrials.eu/ctis-public/view/2024-518013-25-00